EU clinical trial 2025-520571-66-00: CYPENZA - A prospective cohort trial on antiandrogens influences on the pharmacokinetics of corticosteroids.
Sponsor: Region Vaesterbotten (Hospital/Clinic/Other health care facility). Phase: Therapeutic confirmatory (Phase III). Countries: Sweden (ongoing, recruiting).
Therapeutic area(s): Diseases [C] - Male Urogenital Diseases [C12]
Gender: Male. Age: 18-64 years, 65+ years. Enrolment: 30.
Status: Ongoing, recruiting. Start date (EU): 2026-06-30. Decision date: 2026-02-05. Results received: No. Last updated: 2026-06-11.

Condition(s): Prostate cancer
Product: Erleada 60 mg film-coated tablets, Dexacur 4 mg/ml injektions-/infusionsvätska, lösning, Xtandi - 40 mg film-coated tablets

Primary endpoint: The difference in the AUC (area under curve) of dexamethasone serum concentration before, and after steady-state, of two different antiandrogens (enzalutamide or apalutamide).
Endpoint(s): To evaluate the AUC following administration of a doubled dose of dexamethasone during ongoing treatment with antiandrogens (enzalutamide or apalutamide)., To assess whether doubling the corticosteroid dose can compensate for any reduction of the AUC by antiandrogen therapy (enzalutamide or apalutamide)., To evaluate possible adverse events of giving a single dose dexamethasone at three separate occasions.

Source: https://euclinicaltrials.eu/ctis-public/view/2025-520571-66-00